EU clinical trial 2023-508860-31-00: Prophylaxis of venous thromboembolic disease with LMWH (TINzaparin) in patients with metastatic colorectal cancer who start the first line of treatment.
Protocol code: GIT-PRo-2022-02
Sponsor: Grupo Gallego De Investigacion En Tumores Digestivos (Laboratory/Research/Testing facility). Phase: Therapeutic confirmatory (Phase III). Countries: Spain (ended), Portugal (ended).
Therapeutic area(s): Diseases [C] - Neoplasms [C04]; Diseases [C] - Cardiovascular Diseases [C14]; Not possible to specify
Gender: Female, Male. Age: 18-64 years, 65+ years. Enrolment: 631.
Status: Ended. Start date (EU): 2023-02-28. End date (EU): 2025-06-04. Decision date: 2023-11-16. Results received: No. Last updated: 2024-05-22.
Decision dates by country: PT: 2024-05-22, ES: 2023-11-16

Condition(s): Stage IV colon or rectal adenocarcinoma (mCRC).
Product: innohep 8.000 UI anti-Xa/0,4 ml solución inyectable en jeringas precargadas, innohep 4.500 UI anti-Xa/0,45 ml solución inyectable en jeringas precargadas

Primary endpoint: The primary efficacy endpoint is the cumulative incidence of any VTE event including: ● Symptomatic non-fatal pulmonary thromboembolism (PE). ● Symptomatic lower-limb deep vein thromboembolism (sllDVT). ● Symptomatic upper extremity deep vein thromboembolism (sueDVT). ● Incidentally diagnosed PE or proximal DVT. ● Symptomatic central venous catheter thromboembolism. ● Incidentally visceral vein thrombosis (iVVT). ● Symptomatic visceral vein thrombosis (sVVT). ● VTE-related deaths

Source: https://euclinicaltrials.eu/ctis-public/view/2023-508860-31-00